EU clinical trial 2022-500795-62-00: A Phase 2, 2-Part, Open-Label, Single-Arm Study to Investigate the Efficacy and Safety of Dupilumab in Adult and Adolescent Patients with Eosinophilic Gastritis with or without Eosinophilic Duodenitis
Protocol code: R668-EGE-2213
Sponsor: Regeneron Pharmaceuticals Inc. (Pharmaceutical company). Phase: Therapeutic exploratory (Phase II). Countries: Italy (ongoing, recruiting), Poland (ended), France (ended).
Therapeutic area(s): Diseases [C] - Digestive System Diseases [C06]
Gender: Female, Male. Age: 0-17 years, 18-64 years, 65+ years. Enrolment: 19.
Start date (EU): 2024-03-25. Decision date: 2023-10-04. Results received: No. Last updated: 2025-11-12.
Decision dates by country: PL: 2023-10-09, FR: 2024-01-26, IT: 2023-10-04

Condition(s): Eosinophilic gastritis
Product: Placebo matching to dupilumab, Dupixent 300 mg solution for injection in pre-filled syringe

Primary endpoint: Percent change in peak gastric tissue eosinophil count (eos/hpf) from baseline to week 24
Endpoint(s): Proportion of participants achieving a peak gastric eosinophil count of ≤20 eos/hpf up to 52 weeks, Proportion of participants achieving a peak gastric tissue eosinophil count of <30 eos/hpf up to 52 weeks, Proportion of participants achieving both a peak gastric eosinophil count of ≤20 eos/hpf and a peak duodenal eosinophil count <30 eos/hpf up to 52 weeks(assessed for those with both gastric and duodenal involvement), Proportion of participants achieving a peak duodenal eosinophil count of <30 eos/hpf up to 52 weeks (assessed for those with duodenal involvement), Absolute change in the EoG/EoD-SQ TSS from baseline up to 52 weeks, Percent change in the EoG/EoD-SQ TSS from baseline up to 52 weeks, Percent change in peak duodenal tissue eosinophil count (eos/hpf) from baseline up to 52 weeks (assessed for those with duodenal involvement), Absolute change in EoG scores from the EoG Histology Scoring System (EoGHSS) from baseline up to 52 weeks, Change from baseline in frequency of diarrhea episodes up to 52 weeks (assessed for only those with diarrhea at baseline), Change from baseline in frequency of vomiting episodes up to 52 weeks (assessed for only those with vomiting at baseline), Change from baseline up to 52 weeks in the Normalized Enrichment Scores (NES) for the type 2 inflammation transcriptome signature (assessed on gastric tissue), Change from baseline up to 52 weeks in the NES for the type 2 inflammation transcriptome signature (assessed on duodenal tissue from participants with EoD), Change from baseline up to 52 weeks in the NES for the EoG disease (EoG diagnostic panel [EGDP]) transcriptome signature (assessed on gastric tissue), Percent change in peak gastric tissue eosinophil count (eos/hpf) from baseline to week 52, Proportion of participants who receive rescue medications or procedures up to 52 weeks, Other secondary endpoints are specified within the protocol

Source: https://euclinicaltrials.eu/ctis-public/view/2022-500795-62-00